EU clinical trial 2024-515764-31-00: Phase II/III, multisite, randomized master protocol for a global trial of BNT327 in combination with chemotherapy and other investigational agents in first-line non-small cell lung cancer
Protocol code: BNT327-06
Sponsor: BioNTech SE (Pharmaceutical company). Phase: Phase II and Phase III (Integrated). Countries: France (ongoing, recruiting), Germany (ongoing, recruiting), Spain (ongoing, recruiting), Italy (ongoing, recruiting), Belgium (ongoing, recruiting), Poland (ongoing, recruiting), Romania (ongoing, recruiting), Bulgaria (ongoing, recruiting), Hungary (ongoing, recruiting).
Therapeutic area(s): Diseases [C] - Neoplasms [C04]
Gender: Female, Male. Age: 18-64 years, 65+ years. Enrolment: 711.
Status: Ongoing, recruiting. Start date (EU): 2025-06-13. Decision date: 2025-04-29. Results received: No. Last updated: 2026-06-23.
Decision dates by country: PL: 2025-05-05, IT: 2025-04-30, BE: 2025-04-29, ES: 2025-04-30, DE: 2025-04-29, RO: 2025-05-05, BG: 2026-05-11, HU: 2026-05-04, FR: 2025-04-30

Condition(s): Non-small cell lung cancer
Product: PACLITAXEL, BNT327, BNT327, PEMBROLIZUMAB, PEMETREXED, CARBOPLATIN

Primary endpoint: For the Phase II parts of sub-studies A and B: Occurrence of treatment-emergent adverse events (TEAE) (including Grade ≥3), adverse events of special interest (AESIs), treatment-related TEAEs, treatment emergent serious adverse events (SAE), and treatment-related treatment-emergent SAEs in the combination treatment regimen from the first dose of investigational medicinal product (IMP) to the 90-day Follow-Up Visit., For the Phase II parts of sub-studies A and B: Occurrence of dose interruptions, reductions, and discontinuations of IMP due to TEAEs (including related TEAEs) from the first dose of IMP to the 90-day Follow-Up Visit., For the Phase II parts of sub-studies A and B: Objective response rate (ORR) defined as the proportion of participants in whom a confirmed complete response (CR) or confirmed partial response (PR) (per RECIST v1.1 based on the investigator’s assessment) is observed as best overall response., For the Phase II parts of sub-studies A and B: Best percentage change from baseline in tumor size (based on investigator’s tumor assessment according to RECIST 1.1)., For the Phase III parts of sub-studies A and B: Progression-free survival (PFS) defined as the time from randomization to first documented tumour progression (progressive disease assessed by blinded independent central review (BICR) per RECIST v1.1), or death from any cause, whichever occurs first.
Endpoint(s): For the Phase II parts of sub-studies A and B: Duration of response (DOR) defined as the time from first objective response (CR or PR per RECIST v1.1) to first occurrence of objective tumour progression (progressive disease per RECIST v1.1) or death from any cause, whichever occurs first., For the Phase II parts of sub-studies A and B: Disease control rate (DCR) defined as the proportion of participants in whom a confirmed CR or confirmed PR or stable disease (per RECIST v1.1, stable disease assessed at least 6 weeks after randomization) is observed as best overall response., For the Phase III parts of sub-studies A and B: Progression-free survival (PFS) defined as the time from randomization to first documented tumour progression (progressive disease assessed by investigator per RECIST v1.1), or death from any cause, whichever occurs first., For the Phase III parts of sub-studies A and B: Objective response rate (ORR) defined as the proportion of participants in whom a confirmed CR or confirmed PR (per RECIST v1.1) is observed as best overall response., For the Phase III parts of sub-studies A and B: Progression-free survival (PFS) rate as assessed by blinded independent central review (BICR) at 6, 12, and 18 months., For the Phase III parts of sub-studies A and B: PFS rate as assessed by investigator at 6, 12, and 18 months., For the Phase III parts of sub-studies A and B: Overall survival (OS) rate at 6, 12, 18, and 24 months., For the Phase III parts of sub-studies A and B: Change from baseline in EORTC QLQ-C30 Global Health status/Quality-of-Life score (Items 29 and 30)., For the Phase III parts of sub-studies A and B: Change from baseline in EORTC QLQ-C30 physical functioning., For the Phase III parts of sub-studies A and B: Change from baseline in the “coughing” scale of the EORTC QLQ-LC29., For the Phase III parts of sub-studies A and B: Change from baseline in the “shortness of breath” scale of the EORTC QLQ-LC29., For the Phase III parts of sub-studies A and B: Change from baseline in the “coughed-up blood” item of the EORTC QLQ-LC29., For the Phase III parts of sub-studies A and B: Change from baseline in the “fatigue domain” score scale of the NSCLC-SAQ., For the Phase III parts of sub-studies A and B: Change from baseline in the “pain domain” score of the NSCLC-SAQ., For the Phase III parts of sub-studies A and B: Change from baseline in FACT-G overall bother item (FACT-GP5)., For the Phase III parts of sub-studies A and B: Occurrence of treatment-emergent adverse events (TEAEs) including Grade ≥3, serious, and fatal TEAEs by relationship, according to CTCAE v5.0., For the Phase III parts of sub-studies A and B: Occurrence of dose interruptions, reductions, and discontinuations of IMP due to TEAEs (including related TEAEs) from the first dose of IMP to the 90-day Follow-Up Visit., For the Phase III parts of sub-studies A and B: Overall survival (OS) defined as the time from randomization to death from any cause.

Source: https://euclinicaltrials.eu/ctis-public/view/2024-515764-31-00